EU clinical trial 2023-506786-63-00: J2J-OX-JZLC: EMBER-3: A Phase 3, Randomized, Open-label Study of Imlunestrant, Investigator’s Choice of Endocrine Therapy, and Imlunestrant plus Abemaciclib in Patients with Estrogen receptor Positive, HER2 Negative Locally Advanced or Metastatic Breast Cancer Previously Treated with endocrine Therapy
Protocol code: J2J-OX-JZLC
Sponsor: Eli Lilly & Co. (Pharmaceutical company). Phase: Therapeutic confirmatory (Phase III). Countries: France (ongoing, recruitment ended), Netherlands (ended), Germany (ongoing, recruitment ended), Greece (ongoing, recruitment ended), Austria (ongoing, recruitment ended), Belgium (ongoing, recruitment ended), Spain (ongoing, recruitment ended), Italy (ongoing, recruitment ended).
Therapeutic area(s): Diseases [C] - Neoplasms [C04]
Gender: Female, Male. Age: 18-64 years, 65+ years. Enrolment: 263.
Start date (EU): 2021-09-30. Decision date: 2024-03-27. Results received: No. Last updated: 2026-03-24.
Decision dates by country: AT: 2024-04-15, NL: 2024-03-27, GR: 2024-05-20, DE: 2024-04-05, BE: 2024-04-15, IT: 2024-04-11, ES: 2024-04-02, FR: 2024-04-15

Condition(s): Breast Cancer
Product: FULVESTRANT, EXEMESTANE, ABEMACICLIB

Primary endpoint: Investigator-assessed PFS (between Arm A and Arm B) in the ITT population, Investigator-assessed PFS (between Arm A and Arm B) in the ESR1-mutation detected population, Investigator-assessed PFS(between Arm C and Arm A) in the ITT population

Source: https://euclinicaltrials.eu/ctis-public/view/2023-506786-63-00